EU clinical trial 2024-512769-16-00: A Phase II Randomized, Multi-Center, Double-Blind, Global Study to Determine the Efficacy and Safety of Durvalumab plus Olaparib Combination Therapy Compared with Durvalumab Monotherapy as Maintenance Therapy in Patients whose Disease has not Progressed Following Standard of Care Platinum-Based Chemotherapy with Durvalumab in First Line Stage IV NonSmall Cell Lung Cancer (ORION)
Protocol code: D9102C00001
Sponsor: AstraZeneca AB (Pharmaceutical company). Phase: Therapeutic exploratory (Phase II). Countries: Poland (ended).
Therapeutic area(s): Diseases [C] - Neoplasms [C04]
Gender: Female, Male. Age: 18-64 years, 65+ years. Enrolment: 80.
Status: Ended. Start date (EU): 2018-11-14. End date (EU): 2025-01-28. Decision date: 2024-10-07. Results received: No. Last updated: 2024-10-07.

Condition(s): Stage IV Non Small Cell Lung Cancer whose tumors lack EGFR mutations and ALK fusions
Product: Lynparza 150 mg film-coated tablets, IMFINZI 50 mg/mL concentrate for solution for infusion.

Primary endpoint: Progression-free survival (PFS) defined as time from date of randomization until the date of objective radiological disease progression according to Investigator assessment using RECIST 1.1 or death (by any cause in the absence of progression)
Endpoint(s): Overall survival (OS) defined as time from date of randomization until the date of death by any cause, Objective response rate (ORR) defined as percentage of patients with an Investigator-assessed response of CR or PR after randomization, Duration of response (DoR) defined as time from the date of first documented response following randomization until the first date of documented progression or death in the absence of disease progression, PFS in HRRm population defined as time from date of randomization until the date of objective radiological disease progression according to Investigator assessment in HRRm population using RECIST 1.1 or death (by any cause in the absence of progression), Concentration of durvalumab, Disease-related symptoms and HRQoL assessed by change from baseline and time to deterioration (for maintenance phase)in EORTC QLQ-C30 and EORTC QLQ-LC13, Presence of anti-drug antibodies (ADA) for durvalumab, Safety endpoints of AEs, physical examinations, laboratory findings, and vital signs

Source: https://euclinicaltrials.eu/ctis-public/view/2024-512769-16-00